EU clinical trial 2024-511238-11-00: A study to characterise the safety, tolerability and efficacy of LY4170156 in subjects with advanced solid tumors
Protocol code: LOXO-FRA-24001
Sponsor: Eli Lilly & Co. (Pharmaceutical company). Phase: Human Pharmacology (Phase I)- First administration to humans. Countries: Italy (ongoing, recruiting), France (ongoing, recruiting), Spain (ongoing, recruiting).
Therapeutic area(s): Diseases [C] - Neoplasms [C04]
Gender: Female, Male. Age: 18-64 years, 65+ years. Enrolment: 223.
Status: Ongoing, recruiting. Start date (EU): 2024-09-20. Decision date: 2024-08-09. Results received: No. Last updated: 2026-06-08.
Decision dates by country: IT: 2024-08-12, ES: 2024-08-28, FR: 2024-08-09

Condition(s): Ovarian cancer, endometrial cancer, cervical cancer, non-small cell lung cancer, triple-negative breast cancer, pancreatic cancer and colorectal cancer.

Source: https://euclinicaltrials.eu/ctis-public/view/2024-511238-11-00